EU clinical trial 2024-511003-42-00: TAGVEN "Open label phase II study evaluating the efficacy and safety of the combination of tagraxofusp and venetoclax in treatment-naive blastic plasmacytoid dendritic cell neoplasm patients"
Protocol code: TAGVEN
Sponsor: French Innovative Leukemia Organization (Laboratory/Research/Testing facility). Phase: Therapeutic exploratory (Phase II). Countries: France (ongoing, recruiting).
Therapeutic area(s): Diseases [C] - Neoplasms [C04]
Gender: Female, Male. Age: 18-64 years, 65+ years. Enrolment: 33.
Status: Ongoing, recruiting. Start date (EU): 2025-12-11. Decision date: 2025-05-26. Results received: No. Last updated: 2026-07-09.
Decision dates by country: FR: 2025-07-03

Condition(s): BLASTIC PLASMACYTOID DENDRITIC CELL NEOPLASMS
Product: Venetoclax, Venetoclax, ELZONRIS 1 mg/mL concentrate for solution for infusion, Venetoclax

Primary endpoint: Proportion of participants who achieve a cCR after 3 TAGVEN cycles (approximatively 12 weeks) or at end of treatment for patients who stop the treatment prematurely..
Endpoint(s): - Objective response rate including cCR and partial remission after 3 TAGVEN cycles (approximatively 12 weeks) or at end of treatment for patients who stop the treatment prematurely - Safety profile of the tagraxofusp and venetoclax combination - Proportion of patients with MRD - Negative responses measured by flow cytometry - Progression-free Survival - Duration of response - Overall Survival - Proportion of patients bridged to allogeneic stem cell transplantation - Possible predictors of respo

Source: https://euclinicaltrials.eu/ctis-public/view/2024-511003-42-00